EU clinical trial 2024-518964-11-01: An interventional, open-label, Phase II study, to evaluate safety and efficacy of standard and high-dose chemotherapy associated with craniospinal irradiation in patients with metastatic medulloblastoma and other embryonal tumours
Protocol code: MBMET_MEYER2017
Sponsor: Azienda Ospedaliera Universitaria Meyer IRCCS (Hospital/Clinic/Other health care facility). Phase: Therapeutic exploratory (Phase II). Countries: Italy (ongoing, recruitment ended).
Therapeutic area(s): Diseases [C] - Neoplasms [C04]
Gender: Female, Male. Age: 0-17 years, 18-64 years. Enrolment: 18.
Status: Ongoing, recruitment ended. Start date (EU): 2025-01-27. Decision date: 2025-01-27. Results received: No. Last updated: 2025-01-27.

Condition(s): Metastatic medulloblastoma and other embryonal tumours
Product: METHOTREXATE, CARBOPLATIN, LOMUSTINE, CYCLOPHOSPHAMIDE, ETOPOSIDE, THIOTEPA, VINORELBINE

Primary endpoint: Percentage of subjects with neurological symptoms >=G3, evaluated according to CTCAE 4.0, not present at the beginning of postoperative chemoradiotherapy and not related to the recurrence / progression of the disease - Percentage of subjects with SAE - Percentage of subjects with SAE leading to withdrawal from the study - Mortality due to adverse events
Endpoint(s): Progression free survival (PFS) defined as time frame between the date of the enrolment and the date tumour progression or death, Overall survival (OS) defined as time frame between the date of the enrolment and the death to any cause, Difference in scoring for neuropsychological (Griffiths-III, WPPSI-III, WISC-IV, WAIS-IV, Rey, Nepsy-2) and psycological (PedsQL, CBCL) scales, Rate of treatment response: CR, complete response the complete disappearance of all radiographic and/or cytological evidence of tumor; PR, partial response >= 50% reduction in the product of the perpendicular diameters of the tumor with negative cytology - SD, stable disease <= 25%reduction in tumor size; PD, progressive disease >= 25% increase in tumor size or the appearance of tumor in previously uninvolved areas, Frequency of endocrinological and visual sequelae

Source: https://euclinicaltrials.eu/ctis-public/view/2024-518964-11-01